EU clinical trial 2022-502007-30-00: INduction in Sensitized kidney Transplant recipients without pre-Existing donor-specific AntiboDies: a randomized multicentre trial between a lymphocyte depleting and basiliximab (INSTEAD)
Sponsor: Centre Hospitalier Regional Universitaire De Tours (Hospital/Clinic/Other health care facility). Phase: Therapeutic confirmatory (Phase III). Countries: France (ongoing, recruiting).
Therapeutic area(s): Diseases [C] - Pathological Conditions, Signs and Symptoms [C23]
Gender: Female, Male. Age: 18-64 years, 65+ years. Enrolment: 244.
Status: Ongoing, recruiting. Start date (EU): 2023-11-07. Decision date: 2023-06-30. Results received: No. Last updated: 2026-06-12.

Condition(s): Kidney transplant
Product: THYMOGLOBULINE 5 mg/ml, poudre pour solution pour perfusion, Simulect 20 mg powder and solvent for solution for injection or infusion

Primary endpoint: Incidence of BPAR (treated suspicious TCMR and confirmed TCMR with grade ≥ 1 and ABMR) in rATG and basiliximab groups during the first post-transplantation year, determined after blind central reading according to Banff 2019 classification
Endpoint(s): Incidence of BPAR in rATG and basiliximab groups at year 3, Incidence of composite criteria including BPAR, death and graft loss (retransplantation or dialysis) at year 3., Incidence of confirmed TCMR and ABMR in rATG and basiliximab groups at year 1 and 3., Incidence of de novo DSA in rATG and basiliximab groups at year 1 and 3, Incidence of CMV viremia, CMV disease, BKv viremia and BKv nephropathy in rATG and basiliximab groups at year 1 and 3, Estimated glomerular filtration rate (eGFR) according to MDRD formula and proteinuria/creatinuria ratio in rATG and basiliximab groups at day 10, month 1, month 3 and 6, year 1, year 2 and 3, Incidence of primary and secondary outcomes (1 to 6) in subgroups defined by rank of transplantation, Health-Economics endpoints: a) Incremental Cost Utility Ratio (ICUR) estimating the “cost per QALY gained”, at 12 months, from the French Healthcare Insurance perspective, of rATG in comparison to basiliximab. b) Incremental Cost Effectiveness Ratio (ICER) estimating the “cost per prevented BPAR” at 12 months, from the French Healthcare Insurance perspective, of rATG in comparison to basiliximab.

Source: https://euclinicaltrials.eu/ctis-public/view/2022-502007-30-00